EU clinical trial 2023-503723-26-00: Cumulative exposure to Fludarabine in patients undergoing reduced intensity allogeneic stem cell transplantation in Belgium
Protocol code: RIC-FLU
Sponsor: Universitair Ziekenhuis Gent (Hospital/Clinic/Other health care facility). Phase: Therapeutic use (Phase IV). Countries: Belgium (ongoing, recruiting).
Therapeutic area(s): Analytical, Diagnostic and Therapeutic Techniques and Equipment [E] - Therapeutics [E02]; Diseases [C] - Hemic and Lymphatic Diseases [C15]
Gender: Female, Male. Age: 18-64 years, 65+ years. Enrolment: 50.
Status: Ongoing, recruiting. Start date (EU): 2025-06-04. Decision date: 2024-06-18. Results received: No. Last updated: 2025-06-11.

Condition(s): Patients undergoing allogeneic HSCT, for hematological malignancy, following RIC with Fludarabine, Melphalan and ATG.
Product: Fludarabine Sandoz 25 mg/ml concentraat voor oplossing voor injectie of infusie, THYMOGLOBULINE 5 mg/ml poeder voor oplossing voor infusie., Fludarabine Teva 25 mg/ml concentraat voor oplossing voor injectie of infusie, ALKERAN 50 mg poeder en oplosmiddel voor oplossing voor infusie , Grafalon 20 mg/ml concentraat voor oplossing voor infusie.

Primary endpoint: Area under the curve (AUC) of F-Ara-A after exposure to Fludarabine in the context of reduced intensity conditioning with Fludarabine, Melphalan and anti-thymocyte globulin (ATG). To be assessed after the last included patient has finished conditioning regimen.
Endpoint(s): Association between F-Ara-A AUC and creatinine clearance; To be assessed after the last included patient has finished conditioning regimen, Association between F-Ara-A AUC and bodyweight/BMI; To be assessed after the last included patient has finished conditioning regimen., Influence of F-Ara-A AUC on non-relapse mortality, relapse rate, progression free survival and overall survival; To be assessed when: - the first 25 included patients have reached 1 year, 2 years and 3 years of follow-up post-transplant. - all included patients have reached 1 year, 2 years and 3 years of follow-up post-transplant., Influence of F-Ara-A AUC on median time to neutrophil and platelet engraftment; To be assessed when: - the first 25 included patients have reached 1 year of follow-up post-transplant. - all included patients have reached 1 year of follow-up post-transplant., Influence of F-Ara-A AUC on peripheral CD4 and CD8 T-cell count. To be assessed when: - the first 25 included patients have reached 1 year, 2 years and 3 years of follow-up post-transplant. - all included patients have reached 1 year, 2 years and 3 years of follow-up post-transplant., Influence of F-Ara-A AUC on incidence of central nervous system complications/events in the first year after allogeneic stem cell transplant., Applicability of pharmacokinetic model published by Langenhorst et al (6) on the study population to predict F-Ara-A AUC.

Source: https://euclinicaltrials.eu/ctis-public/view/2023-503723-26-00